EU clinical trial 2022-501522-38-00: An Extension Study of Venetoclax for Subjects Who Have Completed a Prior Venetoclax Clinical Trial
Protocol code: M19-388
Sponsor: Abbvie Deutschland GmbH & Co. KG (Pharmaceutical company). Phase: Therapeutic confirmatory (Phase III). Countries: Ireland (ended), Greece (ongoing, recruitment ended), Poland (ongoing, recruitment ended), Denmark (ongoing, recruitment ended), Belgium (ongoing, recruitment ended), Spain (ongoing, recruitment ended), France (ongoing, recruitment ended).
Therapeutic area(s): Diseases [C] - Neoplasms [C04]
Gender: Female, Male. Age: 18-64 years, 65+ years. Enrolment: 29.
Start date (EU): 2020-09-04. Decision date: 2023-03-07. Results received: No. Last updated: 2026-06-30.
Decision dates by country: IE: 2023-03-07, ES: 2023-03-08, GR: 2023-03-07, BE: 2023-03-14, PL: 2023-03-08, FR: 2023-03-09, DK: 2023-03-07

Condition(s): Chronic lymphocytic leukemia; Non-Hodgkin's lymphoma; Multiple Myeloma; Acute Myeloid Leukemia, Acute Lymphocytic Leukemia
Product: Venetoclax, Venetoclax

Primary endpoint: Adverse event collection

Source: https://euclinicaltrials.eu/ctis-public/view/2022-501522-38-00